EU clinical trial 2025-523750-14-00: A phase III randomised, double-blind, placebo-controlled, multicentre efficacy and safety clinical trial of angiotensin II in paediatric patients of 0 to 17 years of age with refractory hypotension in distributive shock receiving fluid resuscitation and standard-of-care vasopressors
Protocol code: CRH07
Sponsor: Paion Pharma GmbH (Pharmaceutical company). Phase: Therapeutic confirmatory (Phase III). Countries: Italy (authorised, recruitment pending), Germany (authorised, recruitment pending), France (authorised, recruitment pending), Spain (authorised, recruitment pending).
Therapeutic area(s): Diseases [C] - Cardiovascular Diseases [C14]
Gender: Female, Male. Age: 0-17 years. Enrolment: 143.
Status: Authorised, recruitment pending. Decision date: 2026-04-30. Results received: No. Last updated: 2026-08-07.
Decision dates by country: ES: 2026-05-07, FR: 2026-04-30, IT: 2026-05-07, DE: 2026-04-30

Condition(s): refractory hypotension in distributive shock
Product: Giapreza 2.5 mg/ml concentrate for solution for infusion, SODIUM CHLORIDE SOLUTION 0.9%

Primary endpoint: Change in the dose of SOC vasopressors, expressed as norepinephrine base equivalent dose (NED) sum/hour, from baseline to the first 6 hours of IMP
Endpoint(s): Change in MAP as mean/h from baseline to the first 3 hours, 3–6, 6–12, 12–24, 24–48 hours, Change in the dose of SOC vasopressors, expressed as norepinephrine base equivalent dose (NED) sum/hour, from baseline to the first 3 hours, 3–6, 6–12, 12–24, 24–48 hours, Time from start of IMP administration to first maintenance dose sustained at the same dose for ≥ 1 hour, and the dose at that time, Change in paediatric logistic organ dysfunction (PELOD-2) score from baseline (all participants are at the PICU at baseline) to 48 hours (for participants who remain at the PICU at this time) and to day 7 (for participants who remain at the PICU at this time), Change in blood lactate from baseline to 6, 12, 24 and 48 hours, Proportion of participants who achieve a ≥ 25%, ≥ 50% and ≥ 75% reduction in the dose of SOC vasopressors, expressed as NED sum/hour, from baseline to 6 hours, and who are alive, blinded to their treatment assignment, and have not been withdrawn at 6 hours

Source: https://euclinicaltrials.eu/ctis-public/view/2025-523750-14-00